EU clinical trial 2024-516569-35-00: A single-centre, randomized, double blind, placebo controlled, crossover, single dose clinical trial to compare orodispersible presentations of bilastine, ebastine, and desloratadine in the suppression of wheal and flare induced by intradermal histamine in healthy volunteers.
Sponsor: Faes Farma S.A., A. Menarini Industrie Farmaceutiche Riunite S.r.l. (Pharmaceutical company). Phase: Therapeutic use (Phase IV). Countries: Spain (ended).
Therapeutic area(s): Diseases [C] - Immune System Diseases [C20]
Gender: Female, Male. Age: 18-64 years. Enrolment: 26.
Status: Ended. Start date (EU): 2025-05-09. End date (EU): 2025-07-11. Decision date: 2025-04-10. Results received: Yes. Last updated: 2025-04-10.

Condition(s): Allergy
Product: Placebo, Desloratadine 5 mg orodispersible tablets, Bactil Flas 10 mg Liofilizados orales, Bilaxten 20 mg comprimidos bucodispersables

Primary endpoint: Onset of action: defined as the first time point (h) in which active treatments show a statistically significant difference in the inhibition of wheal and flare surface areas in comparison to that induced by placebo
Endpoint(s): Percentage of reduction vs placebo: % of reduction of wheal and flare surface areas obtained in each time point after studies drugs administration versus placebo., Percentage of reduction vs baseline: % of reduction of wheal and flare surface areas obtained in each time point after studies drugs administration, in comparison to their corresponding baseline value expressed in cm2, Maximum effect: maximum percentage of reduction of wheal and flare surface areas, Maximum effect time: time point (h) in which the maximum percentage of reduction of wheal and flare surface areas is reached, Duration of effect: last time point (h) where wheal and surface areas show statistically significant differences, compared to placebo and versus baseline, Subjective itching assessment: Mean change versus baseline on subjective itching sensation (VAS)., Tolerability: Changes in the tolerability parameters (clinical laboratory tests, vital signs recording, ECG parameters) evaluated in terms of clinical relevance., Safety: Incidence of adverse events., Pharmacokinetic parameters: Drug plasma concentration and pharmacokinetic parameters (AUC0t, AUC0∞, Cmax, tmax, t1/2, Kel, Cl, Vd) calculated from those plasma levels.

Source: https://euclinicaltrials.eu/ctis-public/view/2024-516569-35-00